EU clinical trial 2024-513299-17-00: Stopping anti-TNF treatment in Crohn's and Colitis patients in remission
Sponsor: Region Skane (Hospital/Clinic/Other health care facility). Phase: Therapeutic use (Phase IV). Countries: Sweden (ongoing, recruiting).
Therapeutic area(s): Diseases [C] - Digestive System Diseases [C06]
Gender: Female, Male. Age: 18-64 years, 65+ years. Enrolment: 350.
Status: Ongoing, recruiting. Start date (EU): 2017-05-05. Decision date: 2024-09-09. Results received: No. Last updated: 2024-09-09.

Condition(s): Ulcerative colitis, Crohn´s disease
Product: Remicade 100 mg powder for concentrate for solution for infusion., Remsima 100 mg powder for concentrate for solution for infusion, Inflectra 100 mg powder for concentrate for solution for infusion, Humira 40 mg/0.8 ml solution for injection

Primary endpoint: The proportion of patients that relapses, as defined by symptomatic scoring in combination with endoscopy, at 12 and 24 months after discontinuation of anti-TNF treatment with identification of factors at study-start that correlate positively or negatively with the event of relapse.
Endpoint(s): Endoscopic scores at 12 and 24 months among those who relapsed compared to those who remained in remission., Fecal calprotectin levels at 12 and 24 months among those who relapsed compared to those who remained in remission., Fecal calprotectin levels at study start among ulcerative colitis patients who relapsed compared to those who remained in remission., The rate of relapse among ulcerative colitis patients with the following fecal calprotectin level ranges (<30 mg/kg for Calpro [C] and <60 mg/kg for Buhlmann [B]; 30-99 mg/kg C and 60-199 mg/kg B; 100-299 mg/kg C and 200-599 mg/kg B; ≥300 mg/kg C and ≥600 mg/kg B., The optimal fecal calprotectin level cut-off with regards to sensitivity and specificity for relapse, for ulcerative colitis and Crohn's disease patients, respectively., Trough concentrations of infliximab and adalimumab among those who relapsed compared to those who remained in remission., The rate of relapse among those with undetectable infliximab or adalimumab trough concentrations, those with 0.5-2.9 ug/ml, 3.0-7.0 ug/ml, >7.0 ug/ml for infliximab, and ≥10.0 ug/ml for adalimumab., The optimal trough concentration cut-off with regards to sensitivity and specificity for relapse, for infliximab and adalimumab, respectively., Area under the infliximab or adalimumab concentration curve during the last therapy cycle among those who relapsed compared to those who remained in remission., Presence of anti-drug antibodies among those who relapsed compared to those who remained in remission., The rate of relapse among those with anti-drug antibodies versus those without., Time to relapse among those who relapse, comparing ADA versus IFX treated and UC versus CD., The level of gut microbiota dysbiosis among those who relapsed compared to those who remained in remission., The rate of relapse among those with a dysbiosis score of 1, 2-3, and 4-5, respectively., Correlation analyses of genes showing high versus low expression in mucosal biopsies and blood samples, with the event of relapse., Correlation analyses of gene-variants with the event of relapse., Additional factors that will be correlated with relapse rates: Endoscopic scores; corticosteroid use between 12 and 6 months before baseline; previous anti-TNF treatment; dose intensification of anti-TNF treatment; mono- versus concomitant immunomodulatortreatment; previously maximal inflammatory extent (Montreal classification); disease duration; extraintestinal manifestations; gender; smoking; hemoglobin; white blood cell count; platelet count; CRP; and histology/immunohistochemistry.

Source: https://euclinicaltrials.eu/ctis-public/view/2024-513299-17-00